EU clinical trial 2025-522007-18-00: A Phase 3 Randomized Study Comparing JNJ-79635322 and an Anti-BCMAxCD3 Bispecific Antibody in Participants With Relapsed or Refractory Multiple Myeloma who Have Received at Least 3 Prior Lines of Therapy Including a PI, an IMiD, and an Anti-CD38 Antibody
Protocol code: 79635322MMY3001
Sponsor: Janssen Cilag International (Pharmaceutical company). Phase: Therapeutic confirmatory (Phase III). Countries: Spain (ongoing, recruiting), Norway (authorised, recruiting), Germany (ongoing, recruiting), Greece (ongoing, recruiting), France (ongoing, recruiting), Italy (ongoing, recruiting), Netherlands (ongoing, recruiting).
Therapeutic area(s): Diseases [C] - Neoplasms [C04]
Gender: Female, Male. Age: 18-64 years, 65+ years. Enrolment: 157.
Start date (EU): 2026-05-27. Decision date: 2026-05-18. Results received: No. Last updated: 2026-06-16.
Decision dates by country: FR: 2026-05-26, DE: 2026-05-20, GR: 2026-05-19, IT: 2026-05-21, ES: 2026-05-22, NO: 2026-05-21, NL: 2026-05-18

Condition(s): Relapsed or Refractory Multiple Myeloma
Product: teclistamab, JNJ-79635322, teclistamab, JNJ-79635322

Primary endpoint: Dual primary endpoints: overall response rate, progression-free survival
Endpoint(s): "VGPR or better CR or better Duration of response MRD-negative CR MRD-negative CR at 9 months Sustained MRD-negative CR (duration ≥12 months) PFS2 OS TTNT", TEAE incidence and severity, laboratory results, and other safety parameters, Change from baseline in HRQoL, symptoms, and functioning using the MySIm-Q, EORTC QLQ-C30, and EQ-5D-5L scores Time to worsening in HRQoL, symptoms, and functioning using the MySIm-Q, EORTC QLQ-C30, and EQ-5D-5L scores Percent of participants with meaningful improvement in HRQoL symptoms, and functioning using the MySIm-Q, EORTC QLQ-C30, and EQ-5D-5L scores, Proportion of participants who report side effects burden on the EORTC IL46, JNJ-79635322 serum concentration, Presence of ADAs and neutralizing antibodies to JNJ-79635322

Source: https://euclinicaltrials.eu/ctis-public/view/2025-522007-18-00